EU clinical trial 2023-505737-26-00: A Randomised, Open label, Multicentre, Phase 3 Trial of First line Treatment with Mesenchymal Stromal Cells MC0518 Versus Best Available Therapy in Adult and Adolescent Subjects with Steroid refractory Acute Graft versus host Disease After Allogeneic Haematopoietic Stem Cell Transplantation (IDUNN Trial)
Protocol code: MC-MSC.1/aGvHD
Sponsor: Medac Gesellschaft fuer klinische Spezialprapaerate mbH (Pharmaceutical company). Phase: Therapeutic confirmatory (Phase III). Countries: Poland (ongoing, recruiting), Spain (ongoing, recruiting), France (ongoing, recruiting), Germany (ongoing, recruiting).
Therapeutic area(s): Diseases [C] - Immune System Diseases [C20]
Gender: Female, Male. Age: 0-17 years, 18-64 years, 65+ years. Enrolment: 198.
Status: Ongoing, recruiting. Start date (EU): 2020-07-22. Decision date: 2024-03-28. Results received: No. Last updated: 2026-06-08.
Decision dates by country: PL: 2024-04-19, FR: 2024-05-07, DE: 2024-03-28, ES: 2024-04-01

Condition(s): Steroid refractory Acute Graft versus host Disease
Product: ANTITHYMOCYTE IMMUNOGLOBULIN (RABBIT), MYCOPHENOLIC ACID, MC0518, EVEROLIMUS

Primary endpoint: Overall response (OR) as defined by complete response (CR) or partial response (PR) at Visit Day 28 relative to aGvHD status at baseline (Visit Day 1 before the first treatment)., OS until Visit Month 24, defined as the time from the date of randomisation to the date of death due to any cause
Endpoint(s): FFTF until 6 months, defined as the time from the date of randomisation to the date of the event. An event is defined as death, relapse or progression of the underlying disease, or addition or change to any further systemic immunosuppressive aGvHD therapy. The diagnosis of cGvHD is considered to be a competing event., aGvHD response at Visit Day 28 assessed by CR, PR, and NR and at Visit Day 60, Visit Day 100, and Visit Day 180 assessed by OR, CR, PR, and NR relative to baseline., Change of aGvHD grade at Visit Day 8, Visit Day 15, Visit Day 22, Visit Day 28, Visit Day 60, Visit Day 100, and Visit Day 180 relative to baseline, Time to response, defined as the time from the date of the first treatment administration to the date of the first response (CR or PR), Duration of the response until Visit Month 24, defined as the time from the date of the first OR (CR or PR) to the date of aGvHD assessed as NR compared with the baseline assessment, or the date of addition or change to any further systemic aGvHD therapy, in responders., Best OR until Visit Day 28 defined as the achievement of an OR at any time point up to and including Visit Day 28, Cumulative dose of steroids given for SR-aGvHD from baseline until Visit Day 60 and until Visit Month 24, Incidence of and time to cGvHD from Visit Day 60 until Visit Month 24, Incidence of graft failure (GF) from baseline until Visit Month 24, Incidence of and time to relapse or progression in subjects with underlying malignant disease from randomisation until Visit Month 24, Event free survival until Visit Month 24, defined as the time from the date of randomisation to the date of the event. An event is defined as GF, relapse or progression of the underlying disease, or death due to any cause., Event free survival until Visit Month 24, defined as the time from the date of randomisation to the date of the event. An event is defined as GF, relapse or progression of the underlying disease, or death due to any cause., The incidence and severity of all adverse events (AEs) until Visit Day 60 or until 30 days after last administration of trial treatment, whichever is later. Thereafter, the incidence of adverse reactions (ARs) will be documented until Visit Month 24., Performance score (Karnofsky / Lansky scale) at Visit Day 8, Visit Day 15, Visit Day 22, Visit Day 28, Visit Day 60, and Visit Day 100 in comparison to the baseline., HRQoL measures: EuroQol 5D 5L (EQ 5D 5L) and the Functional Assessment of Cancer Therapy Bone Marrow Transplantation (FACTBMT) at Visit Day 28, Visit Day 60, Visit Day 100, and Visit Day 180 in comparison to the baseline.

Source: https://euclinicaltrials.eu/ctis-public/view/2023-505737-26-00